EU clinical trial 2025-524911-34-00: A Phase I Study to Evaluate ELA822
Protocol code: ELA822-CP001
Sponsor: Electra Therapeutics Inc. (Pharmaceutical company). Phase: Human Pharmacology (Phase I)- First administration to humans. Countries: Austria (authorised, recruitment pending).
Therapeutic area(s): Diseases [C] - Immune System Diseases [C20]
Gender: Female, Male. Age: 18-64 years. Enrolment: 45.
Status: Authorised, recruitment pending. Decision date: 2026-08-02. Results received: No. Last updated: 2026-08-02.

Condition(s): Healthy Volunteers

Source: https://euclinicaltrials.eu/ctis-public/view/2025-524911-34-00